EU clinical trial 2023-505284-36-00: A Multicenter, Open-label, Phase 2 Basket Study of MK‑7684A, a Co formation of Vibostolimab (MK‑7684) With Pembrolizumab (MK‑3475), With or Without Other Anticancer Therapies in Participants With Selected Solid Tumors (KEYVIBE 005)
Protocol code: MK-7684A-005
Sponsor: Merck Sharp & Dohme LLC (Pharmaceutical company). Phase: Therapeutic exploratory (Phase II). Countries: Spain (ended), Italy (ended), Germany (ended), Poland (ended), France (ended), Netherlands (ended).
Therapeutic area(s): Diseases [C] - Neoplasms [C04]
Gender: Female, Male. Age: 18-64 years, 65+ years. Enrolment: 228.
Status: Ended. Start date (EU): 2021-09-13. End date (EU): 2025-06-27. End date: 2025-08-05. Decision date: 2024-02-06. Results received: Yes. Last updated: 2025-07-01.
Decision dates by country: ES: 2024-02-06, IT: 2024-02-12, PL: 2024-05-31, DE: 2024-02-09, FR: 2024-02-06, NL: 2024-02-06

Condition(s): Advanced solid tumors
Product: PACLITAXEL, KEYTRUDA 25 mg/mL concentrate for solution for infusion, DOCETAXEL, Lenvatinib, BEVACIZUMAB, CAPECITABINE, CARBOPLATIN, FLUOROURACIL, OXALIPLATIN, GEMCITABINE, CISPLATIN, MK-7684A, Lenvatinib

Primary endpoint: Objective Response Rate (ORR) per Response Evaluation Criteria in Solid Tumors (RECIST) 1.1 as Assessed by Blinded Independent Central Review (BICR), Progression-Free Survival (PFS) per RECIST 1.1 as Assessed by BICR, ORR per RECIST 1.1 as Assessed by Investigator, PFS per RECIST 1.1 as Assessed by Investigator at 9 months, PFS per RECIST 1.1 as Assessed by Investigator at 12 months
Endpoint(s): Overall Survival (OS), PFS per RECIST 1.1 as Assessed by Investigator, Duration of Response (DOR) per RECIST 1.1 as Assessed by BICR, DOR per RECIST 1.1 as Assessed by Investigator, ORR per RECIST 1.1 as Assessed by Investigator, Change from Baseline in Global Health Status/Quality of Life Score (European Organisation for Research and Treatment of Cancer Quality-of-Life Questionnaire Core 30 [EORTC QLQ-C30] Items 29 and 30), Change from Baseline in Physical Functioning Score (EORTC QLQ-C30 Items 1-5), Number of Participants Who Experienced One or More Adverse Events (AEs)

Source: https://euclinicaltrials.eu/ctis-public/view/2023-505284-36-00